EU clinical trial 2023-503433-21-00: A Phase 3, Multicenter, Open-label, Long-term Extension Study of Apremilast in Children 2 Years of Age or Older With Oral Ulcers Associated With Behçet’s Disease or 5 Years of Age or Older With Juvenile Psoriatic Arthritis
Protocol code: 20190531
Sponsor: Amgen Inc. (Pharmaceutical company). Phase: Therapeutic confirmatory (Phase III). Countries: Spain (ongoing, recruiting), Italy (ongoing, recruiting), Greece (ongoing, recruiting).
Therapeutic area(s): Diseases [C] - Immune System Diseases [C20]
Gender: Female, Male. Age: 0-17 years, 18-64 years. Enrolment: 25.
Status: Ongoing, recruiting. Start date (EU): 2019-10-03. Decision date: 2023-11-24. Results received: No. Last updated: 2026-07-13.
Decision dates by country: IT: 2024-01-19, ES: 2023-11-24, GR: 2024-01-22

Condition(s): Behçet’s disease is a chronic, relapsing, multisystem inflammatory disorder of unknown etiology characterized by 4 major symptoms (oral aphthous ulcers, genital ulcers, skin lesions, and ocular lesions) and occasionally by 5 minor symptoms (arthritis, gastrointestinal ulcers, epididymitis, vascular lesions, and central nervous system [CNS] symptoms) (Cho, 2012). Juvenile idiopathic arthritis is a heterogeneous group of chronic inflammatory disorders that initially presents in children by the age of 16 years. It refers to arthritis of at least 6 weeks duration of unknown etiology that begins in children less than 16 years old. Juvenile idiopathic arthritis has an annual incidence of 2 to 20 cases per 100 000 population and a prevalence of 16 to 150 cases per 100 000 population. It is an autoimmune disorder marked by abnormalities of immune responses (Adelowo, 2010).
Product: Apremilast, Apremilast, Apremilast

Primary endpoint: Adverse events: Type, frequency, severity, and relationship to apremilast, Columbia-Suicide Severity rating Scale (C-SSRS), Tanner Staging, Body weight, height, and body mass index (BMI), Vital signs and laboratory parameters

Source: https://euclinicaltrials.eu/ctis-public/view/2023-503433-21-00